EU clinical trial 2025-524443-12-00: Randomized adaptive assessment of post COVID syndrome treatments (RAPID): Evaluating the Efficacy of Bupropion for the Treatment of Post-COVID-19 Syndrome-associated Fatigue (ELAPSE)
Protocol code: 2025-03997
Sponsor: Goethe University Frankfurt (Educational Institution). Phase: Therapeutic exploratory (Phase II). Countries: Germany (authorised, recruiting).
Therapeutic area(s): Diseases [C] - Virus Diseases [C02]; Diseases [C] - Respiratory Tract Diseases [C08]
Gender: Female, Male. Age: 18-64 years, 65+ years. Enrolment: 250.
Status: Authorised, recruiting. Start date (EU): 2026-07-15. Decision date: 2026-04-13. Results received: No. Last updated: 2026-05-08.
Decision dates by country: DE: 2026-05-08

Condition(s): Post Covid Syndrome (PCS)
Product: HPMC capsule, size 000, filled with mannitol as placebo and filled with mannitol as a filling agent., Bupropion-ratiopharm 150 mg Tabletten mit veränderter Wirkstofffreisetzung

Primary endpoint: Primary Endpoint (Rank 1): Intra-patient change in intensity of fatigue measured by the FSS total score from Baseline to Day 56, Primary Endpoint (Rank 2): Intra-patient change in physical function as measured by the Short Form-36 Physical Function (SF-36-PF) from Baseline to Day 56
Endpoint(s): Intra-patient change in physical function as measured by the SF-36-PF from Baseline to: a) Day 28 (V4-MOT, mid-treatment assessment) b) Day 84 (V6-EOS, sustained effect 28 days post-treatment), Intra-patient change in intensity of fatigue as measured by the FSS: a) From Screening (V1) to Day 28 (V4-MOT, mid-treatment assessment) b) From Screening (V1) to Day 84 (V6-EOS, sustained effect 28 days post-treatment), Intra-patient change from Baseline to Days 28, 56, and 84 in Depression, anxiety, somatization, and distress symptoms:, a) Severity of depression measured by PHQ-9: from Baseline (V2, Day 1) to Day 28 (V4-MOT), Day 56 (V5-EOT), and Day 84 (V6-EOS) b) Severity of generalized anxiety measured by GAD-7: from Baseline (V2, Day 1) to Day 28 (V4-MOT), Day 56 (V5-EOT), and Day 84 (V6-EOS), c) Severity of somatic symptoms measured by PHQ-15: from Baseline (V2, Day 1) to Day 28 (V4-MOT), Day 56 (V5-EOT), and Day 84 (V6-EOS) d) Severity of psychosocial strain measured by PHQ-stress: from Baseline (V2, Day 1) to Day 28 (V4-MOT), Day 56 (V5-EOT), and Day 84 (V6-EOS), Severity of dyspnea measured by the mMRC: a) From Screening (V1) to Day 28 (V4-MOT, mid-treatment assessment) b) From Screening (V1) to Day 56 (V5-EOT, end of treatment) c) From Screening (V1) to Day 84 (V6-EOS, sustained effect 28 days post-treatment), Intra-patient change from Screening to Days 28 and 56 in: Physical exercise capacity measured by the 1-Minute Sit-to-Stand Test (1MSTS): a) From Screening (V1) to Day 28 (V4-MOT, mid-treatment assessment) b) From Screening (V1) to Day 56 (V5-EOT, end of treatment), Cognitive function measured by the Symbol Digit Modalities Test (SDMT): a) From Screening (V1) to Day 28 (V4-MOT, mid-treatment assessment) b) From Screening (V1) to Day 56 (V5-EOT, end of treatment), Exploratory Endpoints: Biosample collection for future patient stratification: The following materials will be collected at Baseline, Day 1, and Day 56. At both visits, a total volume of 45 mL will be drawn, divided as follows: • Serum • EDTA-Plasma • PBMCs (Heparin blood) • Cytometry / CyTOF (Heparin blood)

Source: https://euclinicaltrials.eu/ctis-public/view/2025-524443-12-00